EU clinical trial 2023-507200-31-00: The efficacy of the use of Cellular Matrix-BCT-HA (combination of autologous platelet-rich plasma and non-cross-linked hyaluronic acid) compared to local estrogen therapy (Blissel, estriol 50 micrograms/g vaginal gel) in women with genitourinary syndrome of menopause. A randomized controlled trial, with a second blind observer.
Protocol code: FSD-CEL-2023-11
Sponsor: Santiago Dexeus Font Fundacio Privada (Laboratory/Research/Testing facility). Phase: Therapeutic use (Phase IV). Countries: Spain (ongoing, recruiting).
Therapeutic area(s): Diseases [C] - Female Urogenital Diseases and Pregnancy Complications [C13]
Gender: Female. Age: 65+ years. Enrolment: 192.
Status: Ongoing, recruiting. Start date (EU): 2024-05-24. Decision date: 2024-04-26. Results received: No. Last updated: 2025-05-15.

Condition(s): genitourinary syndrome of menopause
Product: Blissel 50 microgramos/g gel vaginal., Plasma rich in growth factors

Primary endpoint: The primary efficacy criteria is the percentage of patients with improved symptomatology. Improvement is defined as having a higher score than the baseline in the Vaginal Health Index (VHIS) evaluated at 6 months after treatment.
Endpoint(s): Healing percentage defined as percentage of patients scoring ≥ 15 in the VHIS at 6 months after treatment., Evolution of Vaginal Health Index at 3-months and 6-months follow-up, Evolution of Vulvar Health Index at 3- and 6-months follow-up, Evolution of vaginal pH at 3- and 6-months follow-up, Evolution of Vaginal maturation index (vaginal cytology) at 3- and 6-months follow-up, Evolution of intensity of VVA symptoms (vaginal burning, vaginal itching, vaginal dryness, dyspareunia, and dysuria) will be measured using a 5-cm visual analog scale (VAS) at 3- and 6-months follow-up, Evolution of Female Sexual Distress (FSD) score at 3- and 6-months follow-up, Photographic monitoring at 3- and 6-months follow-up

Source: https://euclinicaltrials.eu/ctis-public/view/2023-507200-31-00